EU clinical trial 2024-517051-12-00: HOVON 176: Golcadomide (CC-99282) for relapsed and refractory primary large B-cell lymphoma of the central nervous system and secondary central nervous system lymphoma: a phase 2 study
Protocol code: HO176
Sponsor: Hemato-Oncologie voor Volwassenen Nederland (Hovon) Stichting (Hospital/Clinic/Other health care facility). Phase: Therapeutic exploratory (Phase II). Countries: Netherlands (ongoing, recruiting), Belgium (ongoing, recruiting).
Therapeutic area(s): Diseases [C] - Hemic and Lymphatic Diseases [C15]; Diseases [C] - Neoplasms [C04]; Diseases [C] - Nervous System Diseases [C10]
Gender: Female, Male. Age: 18-64 years, 65+ years. Enrolment: 74.
Status: Ongoing, recruiting. Start date (EU): 2025-09-16. Decision date: 2025-06-02. Results received: No. Last updated: 2026-08-06.
Decision dates by country: BE: 2025-06-02, NL: 2025-06-02

Condition(s): refractory primary large B-cell lymphoma of the central nervous system, Relapsed primary large B-cel lymphoma of the central nervous system, secondary central nervous system lymphoma
Product: Golcadomide

Primary endpoint: Best overall response achieved during the first 13 treatment cycles
Endpoint(s): Toxicity according to the CTCAE grading, Time to best response, PFS as measured from time of start study treatment until progression or death, OS as measured from time of start study treatment until death of any cause, DOR as measured from first documentation of response until relapse or progression or death, Functional status by MMSE and QoL EORTC QLQ-C30 and EORTC QLQ-BN20, Exploratory endpoint: PK of golcadomide in spinal fluid as compared to plasma, Exploratory endpoint: To examine the value of ctDNA in plasma and spinal fluid for detection of minimal residual disease and the correlation with clinical outcome, Exploratory endpoint: Correlation between mutational and GEP profiles and response to treatment

Source: https://euclinicaltrials.eu/ctis-public/view/2024-517051-12-00